EU clinical trial 2024-519407-99-00: Thiopental Induction Dose during Electroconvulsive therapy for depression (TIDE) - a randomized controlled trial of the effect of anesthetic dose during electroconvulsive therapy for major depression
Sponsor: Karolinska Institutet (Educational Institution). Phase: Therapeutic use (Phase IV). Countries: Sweden (authorised, recruitment pending).
Therapeutic area(s): Psychiatry and Psychology [F] - Mental Disorders [F03]
Gender: Female, Male. Age: 18-64 years, 65+ years. Enrolment: 210.
Status: Authorised, recruitment pending. Decision date: 2025-03-27. Results received: No. Last updated: 2026-07-15.

Condition(s): Major depressive disorder
Product: Pentocur 1 g pulver till injektionsvätska, lösning

Primary endpoint: Change in MADRS score after six ECT sessions with a low thiopental dose compared to a high thiopental dose for anesthesia during ECT for MDD
Endpoint(s): • Seizure duration in the low versus high thiopental dose group • Cognitive side effects within a week after ECT and after six months • The total number of ECT sessions in a series in the low versus high thiopental dose group • Length of hospital stay in the low versus high thiopental dose group • Awareness during anesthesia in the low versus high thiopental dose group • The risk for MDD relapse within a year after ECT in the low versus high thiopental dose group

Source: https://euclinicaltrials.eu/ctis-public/view/2024-519407-99-00